EU clinical trial 2022-501810-77-00: MARSUN: Phase III, Multicenter, Open label, Randomized, Controlled Study Investigating Mosunetuzumab-Lenalidomide versus investigator choices in Patients with Relapsed or Refractory Marginal Zone Lymphoma
Protocol code: MARSUN
Sponsor: Lysarc (Pharmaceutical company). Phase: Therapeutic confirmatory (Phase III). Countries: Germany (ongoing, recruiting), France (ongoing, recruiting), Portugal (ongoing, recruiting), Belgium (ongoing, recruiting), Italy (ongoing, recruiting).
Therapeutic area(s): Diseases [C] - Neoplasms [C04]
Gender: Female, Male. Age: 18-64 years, 65+ years. Enrolment: 260.
Status: Ongoing, recruiting. Start date (EU): 2023-09-01. Decision date: 2023-07-10. Results received: No. Last updated: 2026-07-31.
Decision dates by country: PT: 2023-07-10, BE: 2023-07-10, DE: 2023-07-11, IT: 2025-03-13, FR: 2023-07-10

Condition(s): Relapsed or Refractory Marginal Zone Lymphoma
Product: PREDNISONE BIOGARAN 20 mg, comprimé sécable, Mosunetuzumab, MabThera 1400 mg solution for subcutaneous injection, ENDOXAN 1000 mg, poudre pour solution injectable, DOXORUBICINE ACCORD 2 mg/ml, solution pour perfusion, MabThera 500 mg concentrate for solution for infusion, Mosunetuzumab, LENALIDOMIDE, LENALIDOMIDE, LENALIDOMIDE, LENALIDOMIDE, VINCRISTINE HOSPIRA 2 mg/2 ml, solution injectable, TOCILIZUMAB, BENDAMUSTINE ACCORD 2,5 mg/ml, poudre pour solution à diluer pour perfusion

Primary endpoint: Progression-Free Survival (PFS) from randomization to progression or death from any cause.
Endpoint(s): Complete response rate at 24 months (CR24). The CR24 is defined as the percentage of CR at 24 months from C1D1 among all participants. Participants without response assessment (due to whatever reason) will be considered as non-responder. The CR24 will be determined by blinded central review and by the investigator. This endpoint will be analyzed on the ITT Set., Complete response rate (CRR) other than CR24. The CRR is defined as the percentage of CR among all patients. Patient without response assessment (due to whatever reason) will be considered as non-responder. The CRR will be determined by blinded central review and the investigator., Overall Response Rate (ORR). The ORR is defined as the percentage of complete or partial response among all patients. Patient without response assessment (due to whatever reason) will be considered as non-responder. The ORR will be determined by central review and the investigator., Overall Survival (OS). The overall survival is defined as the time from the date of randomization to the date of death from any cause. Alive patients will be censored at their last contact. This endpoint will be analyzed on the ITT Set., Duration of Response (DOR). The DOR is defined as the time from the first occurrence of a documented objective response (complete or partial response) to progression/relapse or death from any cause. For patients who have not progressed or died at the time of analysis, DOR will be censored at the time of last visit with adequate assessment. This endpoint will be analyzed on the ITT Set., Event-free survival (EFS). EFS is defined as the time from the date of randomization to the event of death from any cause, disease progression or relapse, early discontinuation of the treatment because of any reason or first documented administration of any new anti-lymphoma treatment. Consent withdrawal is not considered as an event for EFS analysis. For patients without event, EFS will be censored at the time of last visit with adequate assessment. This endpoint will be analyzed on ITT Set., Time to next anti-lymphoma treatment (TTNLT). The TTNLT is defined as the time from the date of randomization to the date of first documented administration of any new anti-lymphoma treatment. Patients alive without next anti-lymphoma treatment will be censored at the last visit. Subjects who died (due to any cause) before having received a new anti-lymphoma treatment will be censored on their date of death. This endpoint will be analyzed on the ITT Set., Histological transformation rate. The histological transformation (as determined by investigator) rate is defined as the percentage of transformation from MZL to diffuse large B-cell lymphoma (DLBCL) among all participants. This endpoint will be analyzed on the ITT Set.

Source: https://euclinicaltrials.eu/ctis-public/view/2022-501810-77-00